EU clinical trial 2024-511189-36-00: A Phase 2, Multicenter, Open-label Study of Sotorasib (AMG 510) in Subjects with Stage IV NSCLC whose Tumors Harbor a KRASG12C Mutation in Need of First-Line Treatment (CodeBreak 201)
Protocol code: 20190288
Sponsor: Amgen Inc. (Pharmaceutical company). Phase: Therapeutic exploratory (Phase II). Countries: Belgium (ended), Spain (ended), Sweden (ended), Italy (ended), France (ended).
Therapeutic area(s): Diseases [C] - Neoplasms [C04]
Gender: Female, Male. Age: 18-64 years. Enrolment: 23.
Status: Ended. Start date (EU): 2021-12-23. End date (EU): 2025-07-31. End date: 2026-05-21. Decision date: 2024-05-31. Results received: Yes. Last updated: 2025-07-21.
Decision dates by country: BE: 2024-06-03, ES: 2024-05-31, SE: 2024-06-03, IT: 2024-06-04, FR: 2024-07-04

Condition(s): Non-small cell lung cancer (NSCLC)
Product: SOTORASIB

Primary endpoint: Objective response (OR) (OR = complete response [CR] + partial response [PR]), measured by computed tomography (CT) or magnetic resonance imaging (MRI) and assessed per RECIST 1.1 per Blinded Independent Central Review (BICR)
Endpoint(s): Disease control (CR + PR + stable disease [SD]), Duration of response (DOR), Time to response (TTR), Progression-free survival (PFS), Overall survival (OS), Treatment-emergent adverse events, treatment-related adverse events, and changes in vital signs, electrocardiogram [ECGs], and clinical laboratory tests., PK parameters of sotorasib including, but not limited to, maximum plasma concentration (Cmax), time to achieve Cmax (tmax), and area under the plasma concentration-time curve (AUC)

Source: https://euclinicaltrials.eu/ctis-public/view/2024-511189-36-00